EU clinical trial 2024-518256-23-00: TINNITOX - Botulinum toxin A in tinnitus patients with concurrent bruxism and/or jaw muscle myalgia. A triple blind, randomized, placebo-controlled cross-over trial.
Protocol code: Tinnitox
Sponsor: Sorlandsklinikken (Hospital/Clinic/Other health care facility). Phase: Therapeutic confirmatory (Phase III). Countries: Norway (authorised, recruiting).
Therapeutic area(s): Diseases [C] - Otorhinolaryngologic Diseases [C09]
Gender: Female, Male. Age: 18-64 years, 65+ years. Enrolment: 100.
Status: Authorised, recruiting. Start date (EU): 2025-08-19. Decision date: 2025-04-30. Results received: No. Last updated: 2025-04-30.

Condition(s): Tinnitus
Product: Natriumklorid B. Braun 9 mg/ml oppløsningsvæske til parenteral bruk, BOTOX 100 Allergan-enheter Pulver til injeksjonsvæske, oppløsning

Primary endpoint: Difference in change of the Tinnitus Handicap Inventory (THI) score from baseline to week 18 between the active treatment and the placebo
Endpoint(s): Difference in change of headache score using the Visual Analog Scale (VAS) from baseline to week 18 between the active treatment and the placebo, Difference in change of jaw muscle pain score using the VAS from baseline to week 18 between the active treatment and the placebo, Difference in change of QoL score using EQ-5D-5L questionnaire from baseline to week 18 between the active treatment and the placebo

Source: https://euclinicaltrials.eu/ctis-public/view/2024-518256-23-00